EU clinical trial 2024-512568-72-00: A phase III, single-arm study to evaluate the efficacy and safety of ONCOFID-P-B (paclitaxel-hyaluronic acid conjugate) administered intravesically to patients with BCG unresponsive Carcinoma in Situ of the bladder with or without Ta-T1 papillary disease
Protocol code: R39_21_01
Sponsor: Fidia Farmaceutici S.p.A. (Pharmaceutical company). Phase: Therapeutic confirmatory (Phase III). Countries: France (ongoing, recruitment ended), Spain (ongoing, recruitment ended), Poland (ongoing, recruitment ended), Italy (ongoing, recruitment ended).
Therapeutic area(s): Diseases [C] - Neoplasms [C04]
Gender: Female, Male. Age: 18-64 years, 65+ years. Enrolment: 128.
Status: Ongoing, recruitment ended. Start date (EU): 2023-02-24. Decision date: 2024-05-13. Results received: No. Last updated: 2026-04-10.
Decision dates by country: FR: 2024-05-17, IT: 2024-06-25, ES: 2024-05-13, PL: 2024-06-14

Condition(s): BCG-unresponsive Carcinoma in Situ of the bladder with or without Ta-T1 papillary disease
Product: ONCOFID-P-B

Primary endpoint: CRR at any time within 24 months after induction or re-induction start calculated as the proportion of patients achieving a CR at any time within 24 months after induction or re-induction start. For analysis purpose, CRR will be based on central assessment of response.
Endpoint(s): 1. CRR calculated as the proportion of patients achieving a CR at EOIT/EORIT, 6, 9, 12, 15, 18, 21, 24, 30, 36, 42 and 48 months after induction or re-induction start., 2. DoR defined as the time from first documented evidence of CR to time of documented recurrence (CIS or HG Ta-T1), progression to MIBC, to extravesical disease or death., 3. DoR rate calculated as the proportion of patients who maintained a CR after 6, 9, 12, 15, 18, 21, 24, 30, 36, 42 and 48 months after induction or re-induction start., 4. Progression rate calculated as the proportion of patients with tumor progression to MIBC or extravesical disease at EOIT/EORIT, 15, 24 and 48 months after induction or re-induction start., 5. Time to progression defined as time from induction start to time of documented tumor progression to MIBC or extravesical disease., 6. Proportion of patients undergoing cystectomy for disease progression at EOIT/EORIT, 9, 15, 24 and 48 months after induction or re-induction start., 7. Time to cystectomy defined as time from start of treatment to the date of cystectomy., 8. EFS defined as time from treatment start to the time of documented recurrence after CR, or progression or death due to any cause., 9. OS defined as time from treatment start to death due to any cause.

Source: https://euclinicaltrials.eu/ctis-public/view/2024-512568-72-00